EU clinical trial 2023-504696-24-00: The ALPINE trial: a phase 1-2 study of intra-arterial [177Lu]Lu-PSMA-I&T for progressive or recurrent intracranial adult type diffuse glioma
Sponsor: Erasmus Universitair Medisch Centrum Rotterdam (Erasmus MC) (Hospital/Clinic/Other health care facility). Phase: Phase I and Phase II (Integrated)- First administration to humans. Countries: Netherlands (authorised, recruitment pending), Norway (authorised, recruitment pending).
Therapeutic area(s): Diseases [C] - Nervous System Diseases [C10]; Diseases [C] - Neoplasms [C04]
Gender: Female, Male. Age: 18-64 years. Enrolment: 28.
Status: Authorised, recruitment pending. Decision date: 2023-07-17. Results received: No. Last updated: 2026-05-13.
Decision dates by country: NO: 2026-02-16, NL: 2023-07-17

Condition(s): Glioma (diffuse astrocytoma, oligodendroglioma or glioblastoma)

Source: https://euclinicaltrials.eu/ctis-public/view/2023-504696-24-00